EU clinical trial 2024-514689-38-01: A Phase 2, Randomized, Double-blind, Active-controlled, Dose-ranging, Parallel-design Study of the Efficacy and Safety of Oral VX-993 in Subjects With Painful Diabetic Peripheral Neuropathy
Protocol code: VX24-993-103
Sponsor: Vertex Pharmaceuticals Inc. (Pharmaceutical company). Phase: Therapeutic exploratory (Phase II). Countries: France (ongoing, recruiting), Italy (ongoing, recruiting), Germany (ongoing, recruiting).
Therapeutic area(s): Diseases [C] - Nervous System Diseases [C10]
Gender: Female, Male. Age: 18-64 years, 65+ years. Enrolment: 60.
Status: Ongoing, recruiting. Start date (EU): 2025-05-12. Decision date: 2025-03-26. Results received: No. Last updated: 2026-04-23.
Decision dates by country: DE: 2025-03-31, IT: 2025-03-26, FR: 2025-03-31

Condition(s): Pain Associated With Diabetic Peripheral Neuropathy
Product: PREGABALIN, VX-993 tablet, VX-993 Placebo, VX-993 tablet, PREGABALIN, Pregabalin placebo

Primary endpoint: Change from baseline in the weekly average of daily pain intensity on the numeric pain rating scale (NPRS) at Week 12
Endpoint(s): Proportions of subjects with ≥30%, ≥50%, and ≥70% reductions from baseline in the weekly average of daily pain intensity on the NPRS at Week 12, Safety and tolerability based on adverse events (AEs), laboratory test results, vital signs, and ECGs

Source: https://euclinicaltrials.eu/ctis-public/view/2024-514689-38-01